EU clinical trial 2024-511503-41-00: This study aims to find the best dose of BI 907828 (brigimadlin) in patients with different types of advanced cancer (solid tumors)
Protocol code: 1403-0001
Sponsor: Boehringer Ingelheim International GmbH, Boehringer Ingelheim Espana S.A. (Pharmaceutical company). Phase: Human Pharmacology (Phase I)- Other. Countries: Spain (ended), Belgium (ended), Sweden (ended), Germany (ended), Denmark (ended), Poland (ended).
Therapeutic area(s): Diseases [C] - Neoplasms [C04]
Gender: Female, Male. Age: 18-64 years, 65+ years. Enrolment: 112.
Status: Ended. Start date (EU): 2021-08-13. End date (EU): 2025-11-13. End date: 2025-11-14. Decision date: 2024-09-26. Results received: No. Last updated: 2025-07-23.
Decision dates by country: DE: 2024-10-02, SE: 2024-09-27, BE: 2024-09-26, PL: 2024-10-13, ES: 2024-09-26, DK: 2024-10-02

Condition(s): Advanced or metastatic solid tumors

Source: https://euclinicaltrials.eu/ctis-public/view/2024-511503-41-00